EU clinical trial 2025-521564-35-00: Cangrelor in endovascular stroke treatment with emergent carotid artery stenting (CANCAS)
Sponsor: Medical University Of Graz (Educational Institution). Phase: Therapeutic exploratory (Phase II). Countries: Austria (ongoing, recruiting).
Therapeutic area(s): Diseases [C] - Nervous System Diseases [C10]
Gender: Female, Male. Age: 18-64 years, 65+ years. Enrolment: 50.
Status: Ongoing, recruiting. Start date (EU): 2025-11-06. Decision date: 2025-10-20. Results received: No. Last updated: 2026-07-22.

Condition(s): ischemic stroke with intracranial large artery occlusion of the anterior cerebral circulation
Product: CANGRELOR, CLOPIDOGREL, ACETYLSALICYLIC ACID, ACETYLSALICYLIC ACID, ACETYLSALICYLIC ACID, ACETYLSALICYLIC ACID

Primary endpoint: Carotid artery stent patency at 24 (+/-6) hours after stenting
Endpoint(s): Successful cerebral reperfusion according to modified Thrombolysis In Cerebral Infarction (mTICI) scores 2b-3, Clinical stroke severity according to the National Institutes Health Stroke Scale score at 24 (±6) hours and discharge from hospital or day 7, Modified Rankin Scale score at 90 (±14) days after stroke (telephone assessment allowed), Symptomatic intracranial haemorrhage (ECASS III definition), Major bleeding according to ISTH definition, Intracranial haemorrhage PH1, PH2, class 3 according to Heidelberg Bleeding Classification, In-hospital mortality

Source: https://euclinicaltrials.eu/ctis-public/view/2025-521564-35-00